EU clinical trial 2023-509804-14-00: The role of meldonium and individualized physical activities in the treatment of patients with heart failure
Protocol code: MELD-PHYS-2023
Sponsor: Pauls Stradins Clinical University Hospital (Hospital/Clinic/Other health care facility). Phase: Therapeutic use (Phase IV). Countries: Latvia (authorised, recruiting).
Therapeutic area(s): Diseases [C] - Cardiovascular Diseases [C14]
Gender: Female, Male. Age: 18-64 years, 65+ years. Enrolment: 200.
Status: Authorised, recruiting. Start date (EU): 2024-06-19. Decision date: 2024-03-27. Results received: No. Last updated: 2024-03-27.

Condition(s): Chronic heart failure with preserved ejection fraction
Product: MELDONIUM

Primary endpoint: Physical activity tolerance change asessed by the cardiopulmonary test (relative maximal oxygen uptake, VO2 max ml/min/kg)

Source: https://euclinicaltrials.eu/ctis-public/view/2023-509804-14-00